EU clinical trial 2023-506109-20-00: An interventional, multi-center, randomized, double blinded, placebo controlled study to investigate semaglutide add-on treatment for metabolic control in antipsychotic-using patients (STABIL-NOR – study)
Protocol code: STABIL-NOR study
Sponsor: Helse Bergen HF (Hospital/Clinic/Other health care facility). Phase: Therapeutic confirmatory (Phase III). Countries: Norway (ongoing, recruiting).
Therapeutic area(s): Diseases [C] - Nervous System Diseases [C10]; Diseases [C] - Nutritional and Metabolic Diseases [C18]
Gender: Female, Male. Age: 18-64 years, 65+ years. Enrolment: 140.
Status: Ongoing, recruiting. Start date (EU): 2024-10-19. Decision date: 2024-10-18. Results received: No. Last updated: 2026-05-06.
Decision dates by country: NO: 2024-12-19

Condition(s): Metabolic control in antipsychotic-using patients
Product: Placebo matching active treatment., Wegovy 2.4 mg solution for injection in pre-filled pen

Primary endpoint: The primary endpoints addressing the primary objective: change in body weight from baseline to week 26 of the study
Endpoint(s): Change from baseline at week 0 to week 26 in: o HbA1c (%, mmol /mol) o FPG (mmol/l) o Fasting serum insulin (mIU/L) and insulin C peptid o Lipids (mg/dL) • Total cholesterol • High density lipoprotein (HDL) cholesterol • Low density lipoprotein (LDL) cholesterol • Very low density lipoprotein (VLDL) cholesterol • Free fatty acids • Triglycerides, Change from baseline at week 0 to week 26 in cognition as assessed by the Brief Assessment of Cognition in Schizophrenia (BACS), Time (in days) until discontinuation of AP drug treatment as evaluated through interviews and the measurement of serum levels of antipsychotic drugs, Change from baseline at week 0 to week 26 in the Stunkard scale, The economic outcomes will be assessed in the following way: Analysis of incremental cost-effectiveness ratio (ICER) and a cost-utility analysis based on an well-validated instrument to capture changes in quality of life during the intervention period. These outcomes will also use register-data collected during the 12 months after participation in the RCT. Change in quality of life from baseline at week 0 to week 26 will be assessed by the Manchester Short Assesment of quality of life (MANSA)., Change from baseline at week 0 to week 26 for waist and hip circumference, waist to hip ratio, Change from baseline at week 0 to week 26 in heart rate and blood pressure after 5 minutes at rest, Proportion of participants with T2DM at week 26, Change from baseline at week 0 to week 26 in the ratings of the Calgary Depression Scale for Schizophrenia (CDSS)

Source: https://euclinicaltrials.eu/ctis-public/view/2023-506109-20-00